EU clinical trial 2024-512612-22-00: A randomized double-blind clinical trial comparing Hypochlorous Acid and Polyhexamethylene biguanide in treating diabetic foot ulcers
Protocol code: Dakin´s – Diabetes
Sponsor: Vaestra Goetalandsregionen, University Of Gothenburg (Hospital/Clinic/Other health care facility, Educational Institution). Phase: Therapeutic confirmatory (Phase III). Countries: Sweden (ongoing, recruiting).
Therapeutic area(s): Diseases [C] - Bacterial Infections and Mycoses [C01]
Gender: Female, Male. Age: 18-64 years, 65+ years. Enrolment: 202.
Status: Ongoing, recruiting. Start date (EU): 2021-12-09. Decision date: 2024-11-05. Results received: No. Last updated: 2026-08-07.

Condition(s): Diabetic Foot Ulcer
Product: SODIUM HYPOCHLORITE

Primary endpoint: The primary endpoint variable is difference in the time from baseline (randomization) to healing for patients randomized to treatment with HOCl and PHMB evaluated over 24 weeks of treatment measured as hazard ratio.
Endpoint(s): Proportion healed DFUs in HOCl group versus PHMB group at week 12., The difference in the change of the surface area of the DFU for patients treated with HOCl versus PHMB from baseline (randomization) over 24 weeks., The difference in the change of the depth of the DFU for patients treated with HOCl versus PHMB from baseline (randomization) to week 24., Difference in the mean number of days of antibiotic treatment for patients treated with HOCl versus PHMB from baseline (randomization) to week 24., Difference in the change of quality of life using the EQ5-D questionnaire for patients treated with HOCl versus PHMB from baseline (randomization) to week 24.

Source: https://euclinicaltrials.eu/ctis-public/view/2024-512612-22-00